EU clinical trial 2025-523712-37-00: Effect of COV2 vaccine formulation on the ability to generate antibodies against coronavirus
Protocol code: COV2FIN12
Sponsor: Rokote Laboratories Finland Oy (Pharmaceutical company). Phase: Human Pharmacology (Phase I)- Other. Countries: Finland (ongoing, recruitment ended).
Therapeutic area(s): Diseases [C] - Virus Diseases [C02]
Gender: Female, Male. Age: 18-64 years, 65+ years. Enrolment: 20.
Status: Ongoing, recruitment ended. Start date (EU): 2026-01-21. Decision date: 2025-12-17. Results received: No. Last updated: 2025-12-17.

Condition(s): Booster immunisation against COVID-19 disease caused by SARS-COV-2 Virus

Source: https://euclinicaltrials.eu/ctis-public/view/2025-523712-37-00